EU clinical trial 2022-502043-35-01: A Phase IIIb, Single Arm, Open-label, Multicentre Study of Durvalumab in Combination with Chemotherapy for the First Line Treatment for Patients with Advanced Biliary Tract Cancers (TOURMALINE)
Protocol code: D4191C00140
Sponsor: AstraZeneca AB (Pharmaceutical company). Phase: Therapeutic confirmatory (Phase III). Countries: Germany (ended), Italy (ongoing, recruitment ended), Spain (ongoing, recruitment ended), France (ended).
Therapeutic area(s): Diseases [C] - Digestive System Diseases [C06]
Gender: Female, Male. Age: 18-64 years, 65+ years. Enrolment: 76.
Start date (EU): 2024-04-24. Decision date: 2024-03-14. Results received: No. Last updated: 2026-05-26.
Decision dates by country: DE: 2024-03-27, FR: 2024-03-14, IT: 2024-03-20, ES: 2024-03-15

Condition(s): Advanced Biliary Tract Cancers
Product: Inflectra 100 mg powder for concentrate for solution for infusion, Cisplatin 1 mg/ml Concentrate for Solution for Infusion, Oxaliplatine Accord 5 mg/ml concentraat voor oplossing voor infusie, IMFINZI 50 mg/mL concentrate for solution for infusion., Micofenolato de mofetil Generis 250 mg Cápsulas, Carboplatin 10 mg/ml concentrate for solution for infusion, Gemcitabine 100 mg/ml Concentrate for Solution for Infusion

Primary endpoint: PRAE is defined as an AE which has been assessed by the investigator to be possibly related to study intervention. The measure of interest is the incidence of PRAE Grade 3 or 4 of durvalumab combined with background gemcitabine-based chemotherapy within 6 months after the initiation of durvalumab.
Endpoint(s): • OS is defined as the time from the date of the first dose of study intervention until death due to any cause. The measures of interest are median OS, OS12, OS18, and OS24., • ORR is defined as the proportion of participants who have a confirmed CR or confirmed PR, as determined by the investigator at local site per RECIST 1.1. The measure of interest is the estimate of ORR., • PFS is defined as the time from the first dose of study intervention until the date of PD per RECIST 1.1 as assessed by the investigator, or death due to any cause. The measures of interest are mPFS, PFS12, and PFS18., • DCR is defined as the percentage of participants who have a best objective response of confirmed CR or PR by Week 24/32 or who have demonstrated SD per RECIST 1.1 for at least 24/32 weeks following the start of treatment. The measure of interest is DCR24 and DCR32., • DOR is defined as the time from the date of first documented response until the date of documented progression per RECIST 1.1 as assessed by the investigator or death due to any cause., • DOT is defined as time on study intervention., · Incidence, severity, nature, seriousness, intervention/treatment, outcome, and causality of treatment-emergent AEs, including PRAEs, AESIs, imAEs, and SAEs; AEs resulting in study intervention interruption and discontinuation; and laboratory findings · IRRs and hypersensitivity/anaphylactic reactions, EORTC QLQ-C30: Time to deterioration in global health status (GHS)/QoL, functioning (physical), multi-term symptom (fatigue), single-item symptoms (appetite loss, nausea). Clinically meaningful change from baseline in global health status/QoL, symptoms and function score. Best overall response for GHS/QoL, function and symptom (fatigue). Change from baseline of GHS/QoL, symptom and functioning scores at each post baseline assessment, EORTC QLQ-BIL21: • Time to deterioration in single-item symptoms (abdominal pain, pruritus, and jaundice) • Clinically meaningful change from baseline (categorized as improvement, no change, or deterioration) at each post baseline assessment • Best overall response in single-item symptoms (abdominal pain, pruritus, and jaundice) • Change from baseline for each EORTC QLQ-BIL21 scale/item score at each post baseline assessment

Source: https://euclinicaltrials.eu/ctis-public/view/2022-502043-35-01